EU clinical trial 2025-522702-21-00: A Phase 1, Randomized, Double-Blind, Placebo-Controlled Study in Healthy Participants Followed by a Randomized, Double-Blind, Placebo-Controlled Phase 2 Study in Participants with Moderate-to-Severe Active Ulcerative Colitis.
Protocol code: XmAb942-01 G942-101
Sponsor: Xencor Inc. (Pharmaceutical company). Phase: Therapeutic exploratory (Phase II). Countries: Romania (ongoing, recruiting), Greece (ongoing, recruiting), Bulgaria (ongoing, recruiting), Italy (authorised, recruitment pending), Croatia (ongoing, recruiting), Poland (ongoing, recruiting), Hungary (ongoing, recruiting), France (authorised, recruitment pending), Germany (authorised, recruitment pending), Portugal (authorised, recruiting), Spain (authorised, recruitment pending).
Therapeutic area(s): Diseases [C] - Immune System Diseases [C20]
Gender: Female, Male. Age: 18-64 years, 65+ years. Enrolment: 148.
Start date (EU): 2026-01-26. Decision date: 2026-01-12. Results received: No. Last updated: 2026-05-06.
Decision dates by country: FR: 2026-04-27, DE: 2026-04-29, PT: 2026-03-27, ES: 2026-04-15, HR: 2026-01-15, GR: 2026-01-12, IT: 2026-01-14, RO: 2026-01-19, PL: 2026-01-19, HU: 2026-01-14, BG: 2026-01-19

Condition(s): Ulcerative Colitis is a type of inflammatory bowel disease, a chronic relapsing and remitting gastrointestinal disorder causing inflammation of the colonic and rectal mucosa.
Product: The placebo is a solution of the same formulation excipients at the same concentration and ph as as the xmab942 drug product except that it contains no active ingredient; consists of 20 mm histidine buffer, 7% (w/v) sucrose, and 0.04% polysorbate 80 at ph 6.0.

Primary endpoint: Clinical remission at Week 12, defined as an MMS ≤ 2, with ES of ≤ 1 (excluding friability), a rectal bleeding (RB) subscore of 0, stool frequency (SF) subscore of ≤ 1 (with a ≥ 1 point decrease from baseline).
Endpoint(s): TEAEs, treatment-related TEAEs, SAEs, discontinuations due to treatment related TEAEs., Endoscopic remission defined as an ES ≤ 1 (excluding friability) at Week 12., MMS score at baseline and Week 12., Clinical response at Week 12 defined as: o decrease from baseline in the MMS of ≥ 2 points and at least a 30% reduction from baseline, and o decrease ≥ 1 point in RB from baseline or RB of ≤ 1, Histologic improvement (as defined in the Statistical Analysis Plan [SAP]) at Week 12.

Source: https://euclinicaltrials.eu/ctis-public/view/2025-522702-21-00